EU clinical trial 2025-524697-42-00: EPISSOC : Randomized controlled trial comparing an Early Pleural Irrigation strategy with Saline to the Standard of Care for the management of complicated pleural infections
Protocol code: PI2025_843_0088
Sponsor: Centre Hospitalier Universitaire Amiens Picardie (Hospital/Clinic/Other health care facility). Phase: Therapeutic confirmatory (Phase III). Countries: France (authorised, recruitment pending).
Therapeutic area(s): Diseases [C] - Respiratory Tract Diseases [C08]
Gender: Female, Male. Age: 18-64 years, 65+ years. Enrolment: 244.
Status: Authorised, recruitment pending. Decision date: 2026-05-18. Results received: No. Last updated: 2026-05-18.

Condition(s): Pleural infections
Product: Clindamycin Abcur 150 mg/ml stungulyf/innrennslislyf, lausn., Pulmozyme 2500 U/2.5ml, διάλυμα για εισπνοή μέσω εκνεφωτή, ACTOSOLV 100 000 UI, poudre pour solution injectable/pour perfusion, Linezolid 2 mg/ml solution for infusion, Actilyse 10 mg polvere e solvente per soluzione iniettabile e per infusione, Cefepime AptaPharma 2 g powder for solution for injection/infusion, Piperacilline/Tazobactam Viatris 4 g/500 mg Pulver zur Herstellung einer Infusionslösung, Amoxicilline/Clavulaanzuur IBISQUS 2000 mg/200 mg poeder voor oplossing voor infusie, Vancomycin Viatris 1 000 mg pulver till infusionsvätska, lösning, SODIUM CHLORIDE, CEFOTAXIME VIATRIS 2 g, poudre pour solution injectable (IM - IV), Metronidazole 500 mg/100 ml solution for infusion

Primary endpoint: Treatment failure is defined as a composite outcome that includes death, the need for thoracic surgery, or the requirement for additional intrapleural enzyme therapy following randomisation. This endpoint will be assessed at 30 days.
Endpoint(s): Volume of pleural fluid drained from randomization to day 3, - Incidence of serious and non-serious adverse events, including fever, allergic reactions, bleeding, and chest tube obstruction (assessed on day 3)., Intra-hospital mortality, as well as 30-day and 90-day mortality rates, Rate of thoracic surgery within 30 days, Rate of additional intrapleural enzyme therapy within 30 days., Length of hospital stay from randomization to discharge to home or transfer to a rehabilitation facility.

Source: https://euclinicaltrials.eu/ctis-public/view/2025-524697-42-00